EU clinical trial 2023-506368-14-00: A Multicenter, Open-Label Extension Study to Assess the Long-Term Safety and Tolerability of Dapirolizumab Pegol Treatment in Study Participants With Systemic Lupus Erythematosus
Protocol code: SL0046
Sponsor: UCB Biopharma (Pharmaceutical company). Phase: Therapeutic confirmatory (Phase III). Countries: France (authorised, recruitment pending), Denmark (authorised, recruitment pending), Romania (ended), Czechia (ended), Hungary (ended), Germany (ongoing, recruiting), Spain (ongoing, recruiting), Bulgaria (ended), Poland (ongoing, recruiting), Italy (ongoing, recruiting), Greece (ongoing, recruiting), Belgium (ongoing, recruiting), Netherlands (authorised, recruitment pending).
Therapeutic area(s): Diseases [C] - Immune System Diseases [C20]; Phenomena and Processes [G] - Immune system processes [G12]
Gender: Female, Male. Age: 0-17 years, 18-64 years, 65+ years. Enrolment: 250.
Start date (EU): 2021-09-07. Decision date: 2023-12-13. Results received: No. Last updated: 2026-06-22.
Decision dates by country: RO: 2023-12-15, BG: 2023-12-13, HU: 2023-12-13, CZ: 2023-12-13, BE: 2024-06-03, NL: 2025-09-04, ES: 2023-12-13, IT: 2024-01-08, DE: 2023-12-15, GR: 2024-06-03, DK: 2023-12-13, PL: 2024-01-15, FR: 2023-12-15

Condition(s): Systemic lupus erythematosus (SLE)
Product: DIPHENHYDRAMINE, PARACETAMOL, CILAZAPRIL, Dapirolizumab pegol, EPINEPHRINE

Primary endpoint: 1. Incidence of treatment-emergent adverse events (TEAEs) during the study 2. Incidence of serious treatment-emergent adverse events during the study 3. Incidence of treatment-emergent adverse events (TEAEs) leading to permanent dapirolizumab pegol discontinuation
Endpoint(s): 1. Achievement of prevention of severe BILAG flares (severe BILAG flare-free) through Week 24, 2. Achievement of prevention of severe BILAG flares (severe BILAG flare-free) through Week 52, 3. Achievement of prevention of severe BILAG flares (severe BILAG flare-free) through Week 104, 4. Achievement of LLDAS at ≥50% of all visits, 5. Achievement of BICLA response at Week 24, 6. Achievement of BICLA response at Week 52, 7. Achievement of BICLA response at Week 104

Source: https://euclinicaltrials.eu/ctis-public/view/2023-506368-14-00